EU clinical trial 2025-523736-39-00: Comparative Bioavailability of Levonorgestrel 52 mg Intrauterine System versus Mirena® in Healthy Pre-Menopausal, Non-Pregnant Female Participants.
Protocol code: 2025-LIUD06004-PL-01
Sponsor: Laboratorios Leon Farma S.A. (Pharmaceutical company). Phase: Human Pharmacology (Phase I)- Bioequivalence Study. Countries: Portugal (ongoing, recruiting).
Therapeutic area(s): Not possible to specify
Gender: Female. Age: 18-64 years. Enrolment: 64.
Status: Ongoing, recruiting. Start date (EU): 2025-12-29. Decision date: 2025-11-10. Results received: No. Last updated: 2026-01-21.

Condition(s): No medical condition.

Source: https://euclinicaltrials.eu/ctis-public/view/2025-523736-39-00